EU clinical trial 2023-503223-26-00: A Phase 1 Study of INCB099280 in Combination With Adagrasib in Adults With Advanced Solid Tumors Harboring a KRASG12C Mutation
Protocol code: INCB 99280-204
Sponsor: Incyte Corp. (Pharmaceutical company). Phase: Phase I and Phase II (Integrated)- Other. Countries: Italy (ended), France (not authorised), Spain (ended).
Therapeutic area(s): Diseases [C] - Neoplasms [C04]
Gender: Female, Male. Age: 18-64 years, 65+ years. Enrolment: 75.
Status: Ended. Start date (EU): 2024-05-07. End date (EU): 2024-05-31. End date: 2025-07-11. Decision date: 2024-03-13. Results received: Yes. Last updated: 2024-03-25.
Decision dates by country: FR: 2024-03-18, ES: 2024-03-13, IT: 2024-03-18

Condition(s): Advanced Solid Tumors Harboring a KRASG12C Mutation
Product: INCB099280, Adagrasib

Primary endpoint: DLTs., TEAEs., Impact of TEAEs on study drug administration, assessed by treatment interruptions, dose reductions, and permanent discontinuation.
Endpoint(s): Descriptive summary of PK concentration data for INCB099280 and adagrasib., INCB099280 PK parameters including Cmax,ss, Tmax,ss, Cmin,ss, AUC0-12h, CL/F, and Vz/F from observed INCB099280 plasma concentration time profiles, summarized and analyzed for DDIs., Objective response, defined as having a best overall response of CR or PR assessed per RECIST v1.1 by the investigator., Disease control, defined as having a best overall response of CR, PR, or SD ≥ 15 weeks (from the start of treatment) assessed per RECIST v1.1 by the investigator., DOR, defined as the time from the first CR or PR until disease progression (assessed per RECIST v1.1 by the investigator) or death from any cause, whichever occurs earlier., Six-month and 12-month PFS, defined as absence of disease progression (assessed per RECIST v1.1 by the investigator) or death from any cause from start of treatment to 6 or 12 months.

Source: https://euclinicaltrials.eu/ctis-public/view/2023-503223-26-00